EU clinical trial 2023-505267-36-00: EORTC 2227-BTG: Lomustine with or without reirradiation for first progression of glioblastoma: a randomized phase III study (LEGATO)
Protocol code: EORTC 2227-BTG
Sponsor: European Organisation For Research And Treatment Of Cancer (Patient organisation/association). Phase: Therapeutic confirmatory (Phase III). Countries: Italy (ongoing, recruiting), France (ongoing, recruiting), Norway (ongoing, recruiting), Spain (ongoing, recruiting), Belgium (ongoing, recruiting), Austria (ongoing, recruiting), Germany (ongoing, recruiting), Netherlands (ongoing, recruiting), Denmark (ongoing, recruiting), Czechia (ongoing, recruiting).
Therapeutic area(s): Diseases [C] - Neoplasms [C04]
Gender: Female, Male. Age: 18-64 years, 65+ years. Enrolment: 371.
Status: Ongoing, recruiting. Start date (EU): 2024-03-15. Decision date: 2024-02-20. Results received: No. Last updated: 2025-12-23.
Decision dates by country: AT: 2024-02-26, CZ: 2024-02-20, NL: 2024-02-21, IT: 2024-02-20, ES: 2024-02-21, BE: 2024-02-22, FR: 2024-02-26, DK: 2024-02-20, DE: 2024-02-21, NO: 2024-02-20

Condition(s): Glioblastoma
Product: LOMUSTINE

Primary endpoint: The primary endpoint is OS defined as the number of days from date of enrolment to the date of death due to any cause.
Endpoint(s): PFS. Events are progressions based on Response Assessment in Neuro Oncology (RANO) criteria as determined by the local investigator, Objective and complete response per RANO criteria as assessed by the local investigator, Safety according to the CTCAE (NCI Common Terminology Criteria for Adverse Events) Version 5.0 for toxicity and Serious Adverse Event reporting, QDFS. A deterioration event is defined as ≥10-point worsening from baseline in the GHQ without further improvement (i.e., no subsequent ≥10 point improvement) or death due to any cause, Neurocognitive functioning assessed by Mini Mental State Examination (MMSE)., Health utility, calculated from the collected patient-reported HRQoL data from the QLQ-C30 and patient demographics, Change scores. Changes in HRQoL from baseline in the GHQ/QoL, fatigue, nausea/vomiting, physical, role and social functioning scale scores assessed over time will be evaluated descriptively. Descriptive summaries such as median, range (minimum, maximum), IQR, mean and standard deviation will be provided for all the other scales from the QLQ-C30, QLQ-BN20 and the item list (IL46).

Source: https://euclinicaltrials.eu/ctis-public/view/2023-505267-36-00